EU clinical trial 2023-504870-39-00: A study to learn about how different drugs interact with each drug in a new 7-drug mixture as they move into, through, and out of the body in healthy men
Protocol code: 22387
Sponsor: Bayer AG (Pharmaceutical company). Phase: Human Pharmacology (Phase I)- Other. Countries: Germany (authorised, recruitment pending).
Therapeutic area(s): Not possible to specify
Gender: Male. Age: 18-64 years. Enrolment: 48.
Status: Authorised, recruitment pending. Decision date: 2023-10-23. Results received: No. Last updated: 2023-10-23.

Condition(s): drug-drug interactions (DDI)

Source: https://euclinicaltrials.eu/ctis-public/view/2023-504870-39-00